EU clinical trial 2024-519592-26-00: Treatment of patients with autoantibody-positive autoimmune diseases and severe interstitial lung fibrosis with T lymphocytes transduced by RV-SFG.CD19.CD28.4-1BBzeta retroviral vector - a single center Phase I/II clinical trial (HD-CAR-ILD-1)
Protocol code: HD-CAR-ILD-1
Sponsor: Universitaetsklinikum Heidelberg AöR (Hospital/Clinic/Other health care facility). Phase: Human Pharmacology (Phase I)- Other. Countries: Germany (authorised, recruitment pending).
Therapeutic area(s): Diseases [C] - Immune System Diseases [C20]
Gender: Female, Male. Age: 18-64 years, 65+ years. Enrolment: 10.
Status: Authorised, recruitment pending. Decision date: 2026-08-03. Results received: No. Last updated: 2026-08-03.

Condition(s): Therapy-resistant and progressing lung fibrosis in the course of an autoantibody-positive autoimmune disease like Systemic Sclerosis, ANCA-associated Vasculitis, seropositive Rheumatoid Arthritis, Sjögren’s disease, anti-Synthetase Syndrome or other autoimmune diseases
Product: CD19.CAR T cells

Primary endpoint: Feasibility is defined to comply with a) successful manufacturing (definition see protocol section 3.4) as well as b) application of a CAR.T-cell product and c) tolerability of the procedure (no grade >3 CRS and no grade > 3 ICANS until V11). The primary endpoint is fulfilled if all prerequisites a)-c) are reached in at least 5/6 patients of the total feasibility cohort (3+3 – see protocol “sample size calculation” above) at V11.
Endpoint(s): toxicities measured according to the Common Terminology Criteria for Adverse Events (CTCAE v6.0) or — in case of CRS or ICANS — according to ASTCT grad-ing, Clinical response is defined by improvement in pulmonary function. Improvement is defined as an increase of FVC by >10% plus an at least stable CO-diffusion capaci-ty, defined as no further decrease of more than - 5% from V3 numbers of TLCO/VA and TLCO SB until EOS (V15 of last patient in

Source: https://euclinicaltrials.eu/ctis-public/view/2024-519592-26-00